EU clinical trial 2023-506487-13-00: C4391022 - AN INTERVENTIONAL, OPEN-LABEL, RANDOMIZED, MULTICENTER PHASE 3 STUDY OF PF-07220060 PLUS FULVESTRANT COMPARED TO INVESTIGATOR’S CHOICE OF THERAPY IN PARTICIPANTS OVER 18 YEARS OF AGE WITH HORMONE RECEPTOR-POSITIVE, HER2-NEGATIVE ADVANCED/METASTATIC BREAST CANCER WHOSE DISEASE PROGRESSED AFTER PRIOR CDK 4/6 INHIBITOR-BASED THERAPY
Protocol code: C4391022
Sponsor: Pfizer Inc. (Pharmaceutical company). Phase: Therapeutic confirmatory (Phase III). Countries: Sweden (ended), Czechia (ended), Bulgaria (ended), Hungary (ended), Denmark (ended), Slovakia (ended), Belgium (ended), Italy (ended), Greece (ended), Finland (ended), Germany (ended), Spain (ended), Poland (ended), France (ended).
Therapeutic area(s): Diseases [C] - Neoplasms [C04]
Gender: Female, Male. Age: 18-64 years, 65+ years. Enrolment: 174.
Status: Ended. End date (EU): 2025-02-13. Decision date: 2024-07-16. Results received: No. Last updated: 2024-12-17.
Decision dates by country: FR: 2024-07-18, BE: 2024-07-22, BG: 2024-07-22, CZ: 2024-07-17, DK: 2024-07-16, FI: 2024-07-17, DE: 2024-07-19, GR: 2024-07-22, HU: 2024-07-19, IT: 2024-07-19, ES: 2024-07-17, SE: 2024-07-19, PL: 2024-07-22, SK: 2024-07-19

Condition(s): Hormone receptor-positive, her2-negative advanced/metastatic breast cancer
Product: Afinitor 10 mg tablets, Aromasin 25 mg coated tablets, Faslodex 250 mg solution for injection., Afinitor 5 mg tablets

Primary endpoint: PFS, defined as the time from the date of randomization to the date of first documented disease progression, as determined by blinded independent central review (BICR) per Response Evaluation Criteria in Solid Tumors (RECIST) v1.1, or death due to any cause in the absence of progression of disease (PD), whichever occurs first
Endpoint(s): OS, defined as the time from the date of randomization to the date of death due to any cause, • PFS by investigator • Objective Response (OR) by BICR and by investigator per RECIST v1.1 • Duration of Response (DoR) by BICR and by investigator per RECIST v1.1 • Clinical Benefit Response (CBR: complete response [CR], partial response [PR], or stable disease [SD]/Non-CR/Non-progression of disease [non-PD] ≥24 weeks) by BICR and by investigator per RECIST v1.1., Type, incidence, severity (as graded by the National Cancer Institute Common Terminology for Adverse Events [NCI CTCAE v5.0]), seriousness and relationship to study interventions of adverse events (AEs), and any laboratory test and electrocardiogram (ECG) abnormalities, Patient reported outcomes (PROs) endpoints of global quality of life, symptoms, and functioning assessed using the European Quality of Life 5 Domain 5 Level Scale (EQ-5D-5L), European Organization for the Research and Treatment of Cancer Quality of Life Questionnaire (EORTC QLQ) C30 and EORTC QLQ Breast Cancer Module 23 (BR23), C_trough of PF-07220060

Source: https://euclinicaltrials.eu/ctis-public/view/2023-506487-13-00